EU clinical trial 2024-514861-21-00: Deciphering IL-1 mediated inflammation for the targeted treatment of dilated cardiomyopathy.
Sponsor: Ospedale San Raffaele S.r.l. (Hospital/Clinic/Other health care facility). Phase: Therapeutic exploratory (Phase II). Countries: Italy (ongoing, recruiting).
Therapeutic area(s): Diseases [C] - Immune System Diseases [C20]
Gender: Female, Male. Age: 18-64 years, 65+ years. Enrolment: 24.
Status: Ongoing, recruiting. Start date (EU): 2023-05-25. Decision date: 2024-10-16. Results received: No. Last updated: 2024-10-16.

Condition(s): Inflammatory dilated cardiomyopathy
Product: ANAKINRA

Primary endpoint: Improvement in left-ventricular function, based on the increase of left ventricular (LV) ejection fraction (EF) assessed by transthoracic echocardiography at 4-weeks.

Source: https://euclinicaltrials.eu/ctis-public/view/2024-514861-21-00